EU clinical trial 2024-513861-38-00: A Phase 2b, Randomized, Double-Blind, Placebo-Controlled Study to Evaluate the Efficacy and Safety of EDP-938 in Non-hospitalized Adults with Acute Respiratory Syncytial Virus Infection who are at High Risk for Complications
Protocol code: EDP 938-104
Sponsor: Enanta Pharmaceuticals Inc. (Pharmaceutical company). Phase: Therapeutic exploratory (Phase II). Countries: Slovakia (ended), Spain (ended), Poland (ended), Czechia (ended), Netherlands (ended), Bulgaria (ended).
Therapeutic area(s): Diseases [C] - Respiratory Tract Diseases [C08]
Gender: Female, Male. Age: 18-64 years, 65+ years. Enrolment: 53.
Status: Ended. Start date (EU): 2023-02-02. End date (EU): 2025-06-08. End date: 2025-06-23. Decision date: 2024-07-05. Results received: Yes. Last updated: 2025-05-16.
Decision dates by country: PL: 2024-07-09, SK: 2024-07-08, CZ: 2024-07-10, BG: 2024-07-08, NL: 2024-07-05, ES: 2024-07-05

Condition(s): Respiratory syncytial virus (RSV)
Product: EDP-938, EDP-938 Placebo tablets

Primary endpoint: Time to resolution of RSV Lower Respiratory Tract Disease (LRTD) symptoms (cough, short of breath, wheezing, coughing up phlegm [sputum]) as assessed by the Respiratory Infection Intensity and Impact Questionnaire (RiiQ™) symptom scale through Day 33
Endpoint(s): Clinical efficacy: 1. Time to resolution of each separate RSV LRTD symptom as assessed by RiiQ™ symptom scale score;, 2. Time to resolution of LRTD symptoms and 2 systemic symptoms (feeling feverish and fatigue [tiredness]) as assessed by RiiQ™ symptom scale score;, 3. Time to resolution of all RSV symptoms as assessed by RiiQ™ symptom scale score;, 4. Change from Baseline in severity of RSV LRTD symptoms through Day 33 as assessed by RiiQ™ symptom scale score;, 5. Change from Baseline for RiiQ™ impact scale score through Day 33;, 6. Time to resolution of Upper Respiratory Tract Disease (sore throat and nasal congestion), LRTD, and 2 systemic symptoms through Day 33 as assessed by RiiQ™ symptom scale score;, 7. Time to no or mild impact of RSV disease on daily activities, emotions, and social relationships as assessed by RiiQ™ impact scale score;, 8. Percentage of participants with post-baseline RSV-related complications;, 9. Time to resolution of RSV infection symptoms as assessed by Patient Global Impression of Severity (PGI-S) scale score;, 10. Time to improvement in RSV disease as assessed by Patient Global Impression of Change (PGI-C) scale score;, 11. Change from Baseline for Health-Related Quality of Life (HRQOL) through Day 33 as assessed by EuroQol 5 Dimensions 5 Levels (EQ--5D--5L) questionnaire, 12. Time to return to usual health as assessed by ‘Adult Return to Usual Health’ question;, 13. Time to return to usual activities as assessed by the ‘Adult Return to Usual Activities’ question;, 14. Percentage of subjects with new antibiotic use, or new or increased use of bronchodilators, systemic or inhaled corticosteroids, or oxygen supplementation;, 15. Duration of treatment-emergent use of antibiotics;, 16. Duration of treatment-emergent new use or increased dose of bronchodilators or systemic or inhaled corticosteroids;, 17. Duration of new or increased oxygen supplementation;, 18. Percentage of subjects with unscheduled medically attended visits (i.e., outpatient clinic, urgent care center, or emergency room visits) for RSV infection or other causes;, 19. Percentage of subjects requiring hospitalization for RSV infection or other causes;, 20. Duration of hospitalization for RSV infection or other causes;, 21. Percentage of subjects requiring admission to intensive care unit (ICU) for RSV infection or other causes;, 22. Duration of ICU stay for RSV infection or other causes;, 23. Percentage of subjects requiring invasive or noninvasive mechanical ventilation, 24. Duration of invasive or noninvasive mechanical ventilation;, 25. Duration of treatment-emergent new use or increased use of medications to treat CHF, 26. All-cause mortality., • Antiviral activity: 1. RSV RNA viral load area under the curve (AUC) measured in nasopharyngeal swab samples by quantitative reverse transcription polymerase chain reaction (RT-qPCR) from Baseline at Days 3, 5, 9, and 14;, 2. Percentage of subjects with RSV RNA viral load Target Not Detected (TND) at any point during the study;, 3. Time to RSV RNA viral load below TND;, 4. RSV RNA viral load change from Baseline at Days 3, 5, 9, and 14;, 5. Change in infectious RSV viral load over time by a quantitative cell-based infectivity assay., • Pharmacokinetics: o Plasma concentrations of EDP-938 and its metabolites (EP-024766, EP-024636, EP-024594, and EP-024595);, Safety: o Safety endpoints include, but are not limited to, adverse events (AEs; including serious adverse events [SAEs], severe AEs, and AEs leading to discontinuation of the study drug), and clinically significant changes from baseline in vital sign measurements, pulse oximetry measurements, electrocardiograms (ECGs), and clinical laboratory test results (including chemistry and hematology).

Source: https://euclinicaltrials.eu/ctis-public/view/2024-513861-38-00